EU clinical trial 2023-503424-12-00: Targeting branched-chain amino acid oxidation to improve glycaemic control in patients with type 2 diabetes
Sponsor: Maastricht University (Educational Institution). Phase: Therapeutic use (Phase IV). Countries: Netherlands (ongoing, recruiting).
Therapeutic area(s): Diseases [C] - Nutritional and Metabolic Diseases [C18]
Gender: Female, Male. Age: 18-64 years, 65+ years. Enrolment: 26.
Status: Ongoing, recruiting. Start date (EU): 2025-04-14. Decision date: 2023-07-13. Results received: No. Last updated: 2026-05-12.

Condition(s): Type 2 diabetes
Product: PHEBURANE 483 mg/g granules

Primary endpoint: Glucose levels will be measured after an overnight fast expressed in mmol/l.
Endpoint(s): Glucose clearance in ml/kg determined during an OGTT, O2-flux in pmol/mg/s measured with high resolution respirometry, Endogenous nsulin-stimulated change in respiratory exchange ratio (ΔRER) with use of indirect calorimetry during the OGTT, PCr/ATP-ratio determined with phosphorus magnetic resonance spectroscopy, Cardiac function will be measured in 2 ways: 1) ejection fraction (microL) with use of cine-MRI 2) diastolic cardiac function with use of ultrasound (transthoracic echocardiography) and will be assessed with the following parameters: • Left atrial maximum volume (ml) • Peak E-wave velocity (cm/sec) • Peak A-wave velocity (cm/sec) • Pulsed wave TDI e’velocity (cm/sec) at lateral and septal basal regions • Tricuspid regurgitation systolic jet velocity (m/sec), Cognitive function will be assessed in 2 ways: 1) Use of CANTAB 2) Questionnaires (Beck’s Depression Inventory and Pittsburgh Sleep Quality Index), Continuous glucose profile will be measure with use of the CGM sensor

Source: https://euclinicaltrials.eu/ctis-public/view/2023-503424-12-00